EU clinical trial 2023-504840-32-00: A Randomized, Double-blind, Placebo-controlled, Global Proof-of-concept Study to Evaluate the Efficacy, Safety, and Tolerability of BMS-986446, an Anti-MTBR Tau Monoclonal Antibody, in Participants with Early Alzheimer’s Disease (TargetTau-1)
Protocol code: CN008-0003
Sponsor: Bristol-Myers Squibb Services Unlimited Company (Pharmaceutical company). Phase: Therapeutic exploratory (Phase II). Countries: Sweden (ongoing, recruitment ended), Spain (ongoing, recruitment ended), Belgium (ongoing, recruitment ended).
Therapeutic area(s): Diseases [C] - Nervous System Diseases [C10]
Gender: Female, Male. Age: 18-64 years, 65+ years. Enrolment: 42.
Status: Ongoing, recruitment ended. Start date (EU): 2024-11-08. Decision date: 2024-09-02. Results received: No. Last updated: 2026-07-14.
Decision dates by country: SE: 2024-09-03, BE: 2024-09-02, ES: 2024-09-09

Condition(s): Early Alzheimer’s Disease
Product: PRX005, Florquinitau F-18, Sodium Chloride

Primary endpoint: Change from baseline at Week 76 in brain tau deposition, as measured by tau positron emission tomography (PET)
Endpoint(s): Change from baseline at Week 76 in Clinical Dementia Rating Scale Sum of Boxes (CDR-SB) score, Change from baseline at Week 76 in integrated Alzheimer’s Disease Rating Scale (iADRS) score, Change from baseline at Week 76 in Alzheimer’s Disease Assessment Scale-Cognitive subscale (ADAS- Cog14) score, Change from baseline at Week 76 in Mini Mental State Examination (MMSE) score, Change from baseline at Week 76 in Alzheimer’s Disease Cooperative Study-instrumental Activities of Daily Living scale (ADCS-iADL) score

Source: https://euclinicaltrials.eu/ctis-public/view/2023-504840-32-00